EU clinical trial 2025-520483-17-01: Efficacy and safety of repeated Rituximab infusions in patients with Active Systemic SClerosis and background medication, a one year randomized blinded placebo-controlled trial, the RASSc study.
Sponsor: Radboud universitair medisch centrum Stichting (Hospital/Clinic/Other health care facility). Phase: Therapeutic use (Phase IV). Countries: Netherlands (ongoing, recruiting).
Therapeutic area(s): Diseases [C] - Musculoskeletal Diseases [C05]; Diseases [C] - Immune System Diseases [C20]
Gender: Female, Male. Age: 18-64 years, 65+ years. Enrolment: 105.
Status: Ongoing, recruiting. Start date (EU): 2025-09-02. Decision date: 2025-05-22. Results received: No. Last updated: 2025-11-25.

Condition(s): Systemic sclerosis
Product: Sodium Chloride Fresenius Kabi Italia 0,9 % Solution for infusion, MabThera 500 mg concentrate for solution for infusion

Primary endpoint: The primary outcome will be between group differences of disease progression after 12 months follow-up. Disease progression is defined as a dichotomized composite outcome measure representing a clinical relevant worsening in skin and/or lung involvement, defined as: A) Increase in modified Rodnan Skin Score of 3 points and/or 15%, and/or B) Decrease ≥ 10% in FVC, or a decrease in FVC ≥ 5%-< 10% and a decline in DLCO ≥ 15%, and/or new ILD on HRCT-scan.
Endpoint(s): Secondary outcomes will be assessed during follow-up, after 12 and 18 months. Secondary outcomes include between group differences in other organ involvement, the derived composite outcome CRISS if applicable, changes in nailfold capillaroscopic findings, change in functionality, quality of life, patient satisfaction, mortality, safety and cost-effectiveness with an economic evaluation.

Source: https://euclinicaltrials.eu/ctis-public/view/2025-520483-17-01